EU clinical trial 2025-523425-17-00: PODOMOUNT-Basket, a Phase II, multicentre, randomised, 2-arm parallel-group, double-blind, placebo-controlled basket trial to assess safety, tolerability, PK, and efficacy of BI 764198 in four proteinuric kidney diseases
Protocol code: 1434-0027
Sponsor: Boehringer Ingelheim International GmbH, Boehringer Ingelheim Espana S.A. (Pharmaceutical company). Phase: Therapeutic exploratory (Phase II). Countries: Portugal (ongoing, recruiting), Greece (authorised, recruitment pending), Italy (authorised, recruiting), Poland (authorised, recruiting), Estonia (authorised, recruitment pending), Slovakia (authorised, recruiting), Sweden (authorised, recruitment pending), Denmark (authorised, recruitment pending), Belgium (authorised, recruitment pending), Norway (authorised, recruitment pending), Romania (ongoing, recruiting), France (ongoing, recruiting), Spain (ongoing, recruiting), Germany (authorised, recruiting), Netherlands (authorised, recruitment pending), Croatia (ongoing, recruiting).
Therapeutic area(s): Diseases [C] - Nutritional and Metabolic Diseases [C18]
Gender: Female, Male. Age: 0-17 years, 18-64 years, 65+ years. Enrolment: 66.
Start date (EU): 2026-06-03. Decision date: 2026-05-19. Results received: No. Last updated: 2026-05-25.
Decision dates by country: DE: 2026-05-22, BE: 2026-05-21, HR: 2026-05-25, DK: 2026-05-21, EE: 2026-05-21, FR: 2026-05-20, GR: 2026-05-21, IT: 2026-05-21, PT: 2026-05-20, RO: 2026-05-25, ES: 2026-05-22, SE: 2026-05-20, NL: 2026-05-20, NO: 2026-05-19, PL: 2026-05-25, SK: 2026-05-19

Condition(s): Proteinuric kidney diseases
Product: Placebo matching BI 764198, BI 764198

Primary endpoint: Relative change from baseline to Week 20 in 24-hr UPCR (mg/g)
Endpoint(s): Treatment response, defined as at least 25% relative reduction in 24-hr UPCR from baseline to Week 20, Treatment response, defined as at least 40% relative reduction in 24-hr UPCR from baseline to Week 20, Absolute change in eGFR in mL/min/1.73m2 (based on cystatin C) from baseline to Week 20

Source: https://euclinicaltrials.eu/ctis-public/view/2025-523425-17-00